EU clinical trial 2024-512358-78-00: A Phase I/II Study of MCLA-128, a full length IgG1 Bispecific Antibody Targeting HER2 and HER3, in Patients with Solid Tumors (eNRGy)
Protocol code: MCLA-128-CL01
Sponsor: Partner Therapeutics Inc. (Pharmaceutical company). Phase: Phase I and Phase II (Integrated)- First administration to humans. Countries: France (ended), Austria (ended), Sweden (ended), Spain (ended), Belgium (ended), Germany (ongoing, recruiting), Denmark (ended), Netherlands (ended), Italy (ongoing, recruiting), Norway (ended).
Therapeutic area(s): Diseases [C] - Neoplasms [C04]
Gender: Female, Male. Age: 18-64 years, 65+ years. Enrolment: 341.
Start date (EU): 2015-01-20. Decision date: 2024-04-02. Results received: No. Last updated: 2026-04-16.
Decision dates by country: SE: 2024-04-02, DK: 2024-04-02, BE: 2024-04-15, NO: 2024-04-03, AT: 2024-04-08, NL: 2024-04-02, DE: 2024-04-08, IT: 2024-04-04, ES: 2024-04-02, FR: 2024-04-24

Condition(s): Solid Tumors
Product: MCLA-128

Primary endpoint: Part 1: Evaluation of adverse events (AEs) and dose limiting toxicities (DLT)., Part 2: Groups A - E, and F: • Frequency and nature of AEs. • Overall response rate (ORR), Duration of Response (DOR), Clinical Benefit Rate (CBR), Part 2: Groups F, G, H (NRG1 fusion): • ORR per RECIST v1.1 as per local Investigator's assessment. • DOR per RECIST v1.1 as per local Investigator's assessment.
Endpoint(s): Part 1: 1. Frequency and nature of AEs/serious adverse events (SAEs). 2. Assessment of PK variables. 3. Incidence and serum titers of anti-drug antibodies against MCLA-128. 4. Anti-tumor activity and clinical benefit assessed by RECIST v1.1 determining ORR, DOR, progression-free survival (PFS) and survival., Part 2: Groups A - E, and F : 5. Assessment of PK variables. 6. Population PK analysis. 7. Incidence and serum titers of anti-drug antibodies against MCLA-128., Part 2: Groups F, G, H (NRG1 fusion): ORR per RECIST v1.1. CBR per RECIST v1.1. DOR per RECIST v1.1. Time to response per RECIST v1.1 Frequency and nature of AEs. Assessment of PK variables. Population PK analysis. Incidence and serum titers of anti-drug antibodies against MCLA-128.

Source: https://euclinicaltrials.eu/ctis-public/view/2024-512358-78-00